EU clinical trial 2023-508645-40-00: A Phase 2/3, Randomized, Double-Blinded, Placebo-Controlled, Parallel-Group Study to Investigate the Efficacy and Safety of Efgartigimod PH20 SC in Adult Participants With Bullous Pemphigoid
Protocol code: ARGX-113-2009
Sponsor: Argenx (Pharmaceutical company). Phase: Phase II and Phase III (Integrated). Countries: Czechia (ended), Italy (ended), Spain (ended), Hungary (ended), Slovakia (ended), Bulgaria (ended), Romania (ended), Netherlands (ended), Croatia (ended), Germany (ended), Greece (ended), Poland (ended), France (ended), Latvia (ended).
Therapeutic area(s): Diseases [C] - Immune System Diseases [C20]
Gender: Female, Male. Age: 18-64 years, 65+ years. Enrolment: 90.
Status: Ended. Start date (EU): 2022-05-10. End date (EU): 2024-09-13. End date: 2024-09-14. Decision date: 2024-02-01. Results received: Yes. Last updated: 2024-08-22.
Decision dates by country: RO: 2024-02-05, GR: 2024-03-07, IT: 2024-03-11, FR: 2024-02-01, PL: 2024-02-02, BG: 2024-02-05, SK: 2024-02-01, HU: 2024-02-02, CZ: 2024-02-06, DE: 2024-02-13, HR: 2024-02-02, LV: 2024-02-01, NL: 2024-02-02, ES: 2024-02-05

Condition(s): Bullous Pemphigoid (BP)
Product: PREDNISONE, PREDNISONE, ARGX-113, PREDNISONE, PREDNISONE, PBO PH20 SC

Primary endpoint: Proportion of participants who are in complete remission (CR) while receiving efgartigimod PH20 SC or placebo and have been off oral corticosteroid (OCS) therapy for ≥8 weeks at week 36
Endpoint(s): Cumulative dose of OCS from baseline to week 36, Proportion of participants who achieve an Investigator Global Assessment of Bullous Pemphigoid (IGA-BP) score of 0 while receiving efgartigimod PH20 SC or placebo and have been off OCS therapy for ≥8 weeks at week 36, Proportion of participants who achieve an Investigator Global Assessment of Bullous Pemphigoid (IGA-BP) score of 0 or 1 while receiving efgartigimod PH20 SC or placebo and have been off OCS therapy for ≥8 weeks at week 36, Proportion of participants who achieve an IGA-BP score of 0 or 1 while receiving efgartigimod PH20 SC or placebo at any time through week 36, Proportion of participants who receive rescue therapy before week 36, Proportion of participants who achieve control of disease activity (CDA) while receiving efgartigimod PH20 SC or placebo and remain free of relapse through week 36, Proportion of participants who are in CR while receiving efgartigimod PH20 SC or placebo and have been receiving minimal OCS therapy for ≥8 weeks at week 36. (Minimal OCS therapy is defined as ≤0.1 mg/kg/day of prednisone [or an equivalent dose of another OCS].), Changes from baseline in the BPDAI activity score, Changes from baseline in the 24-hour average itch score from the Itch Numerical Rating Scale (NRS), Changes from baseline in the 24-hour worst itch score from the Itch Numerical Rating Scale (NRS), Time to achieve the following: - CDA - CR - CR while on minimal OCS therapy for ≥8 weeks - CR/PR while off OCS therapy for ≥8 weeks - CR while off OCS therapy for ≥8 weeks - Relapse, Cumulative OCS dose for the participant at the time points when they exhibit the following: - CDA - CR - CR while on minimal OCS therapy for ≥8 weeks - CR/PR while off OCS therapy for ≥8 weeks - CR while off OCS therapy for ≥8 weeks - Relapse, Incidence and severity of TEAEs, AESIs, and SAEs, The Aggregate Improvement Score (AIS) from the GTI, The Cumulative Worsening Score (CWS) from the GTI, The GTI Specific List (GTI-SL), EQ-5D-5L scores over time, DLQI scores over time, ABQoL scores over time, EFG serum concentrations, Percentage change of total IgG serum levels from baseline over time, Percentage change of anti-BP180 and anti-BP230 antibodies from baseline over time, Incidence and prevalence of antidrug antibodies (ADA) against efgartigimod (in serum) and antibodies against rHuPH20 (in plasma), Number and percentage of participants (or their caregivers) who complete the (self-)administration training at study sites, Number and percentage of participants (or their caregivers) who are determined by site staff to be sufficiently competent in (self-)administering efgartigimod PH20 SC, Number and percentage of participants (or their caregivers) who successfully (self-)administer efgartigimod PH20 SC under site staff supervision

Source: https://euclinicaltrials.eu/ctis-public/view/2023-508645-40-00